EU clinical trial 2025-523481-24-00: A Phase III, randomized, placebo-controlled, parallel group, double-blind study to evaluate the efficacy and safety of NIO752 in participants with Progressive Supranuclear Palsy followed by an Open Label Extension
Protocol code: CNIO752A12301
Sponsor: Novartis Pharma AG (Pharmaceutical company). Phase: Therapeutic confirmatory (Phase III). Countries: Netherlands (authorised, recruitment pending), Germany (ongoing, recruiting), Spain (ongoing, recruiting), Italy (ongoing, recruiting), France (ongoing, recruiting), Belgium (authorised, recruitment pending).
Therapeutic area(s): Diseases [C] - Nervous System Diseases [C10]
Gender: Female, Male. Age: 18-64 years, 65+ years. Enrolment: 138.
Start date (EU): 2026-06-24. Decision date: 2026-04-21. Results received: No. Last updated: 2026-07-24.
Decision dates by country: FR: 2026-04-27, IT: 2026-06-03, ES: 2026-04-27, NL: 2026-04-21, DE: 2026-06-02, BE: 2026-06-12

Condition(s): Participants with Progressive Supranuclear Palsy Richardson Syndrome (PSP-RS)
Product: Isotone Kochsalz-Lösung 0,9 % Braun Infusionslösung, NIO752

Primary endpoint: Change from baseline at Week 72 in the rPSPRS-10 score
Endpoint(s): Change from baseline at Week 72 in the PSPRS-28, Changes from baseline at Week 72 in activities of daily living on the XXX, Change from baseline at Week 72 in the Progressive Supranuclear Palsy Quality of Life scale (PSP-ShoQoL), Change from baseline at Week 72 in the Category Fluency, Phonemic Fluency, Symbol Digit Modality Test (SDMT), and Letter-Number- Sequencing (LNS), Changes from baseline in volumes of ventricles, whole brain, midbrain, pons, superior cerebellar peduncle, third ventricle, frontal lobe as measured by MRI until Week 72., Safety and tolerability parameters including AEs, AESIs, SAEs (including SAEs with fatal outcomes), AEs leading to XXX and treatment interruptions, AEs leading to dose discontinuation, clinical laboratory evaluations, vital signs, electrocardiogram (ECG), XXX

Source: https://euclinicaltrials.eu/ctis-public/view/2025-523481-24-00